EU clinical trial 2024-514852-34-01: Prospective pilot study of L-dopa treatment in patients with a neurodevelopmental disorder linked to a pathogenic variant of the CTNNB1 gene
Protocol code: RECHMPL23_0426
Sponsor: Centre Hospitalier Universitaire De Montpellier (Hospital/Clinic/Other health care facility). Phase: Therapeutic exploratory (Phase II). Countries: France (authorised, recruiting).
Therapeutic area(s): Diseases [C] - Nervous System Diseases [C10]
Gender: Female, Male. Age: 0-17 years. Enrolment: 7.
Status: Authorised, recruiting. Start date (EU): 2026-04-08. Decision date: 2025-08-14. Results received: No. Last updated: 2026-01-29.

Condition(s): Neurodevelopmental disorders, rare disease, CTNNB1
Product: Lévodopa 3mg/kg/j, Carbidopa 0.3mg/Kg/j, Carbidopa 0.75mg/Kg/j

Primary endpoint: GMFM-88 motor score before treatment (Day 1) and at 6 months
Endpoint(s): GMFM-88 motor score before treatment (Day 1) and at 12 months, Changes in language/development/cognition assessment scores (Bayley III, WPPSI, WISC, Vineland), before treatment and at 1 year after treatment, Changes in quality-of-life scores (Caregiver Priorities & Child Health Index of Life with Disabilities (CP-CHILD), Clinical Global Impression of severity scale (CGI)) before treatment, at 6 months and at 1 year after initiation of treatment, Tolerance assessment (number and severity of adverse events, clinical follow-up, clinical, neurological and osteoarticular examination, patient logbook)., GMFM-88 motor score between 6 and 12 months of treatment

Source: https://euclinicaltrials.eu/ctis-public/view/2024-514852-34-01